EU clinical trial 2025-521591-64-00: RUBY study « Randomized controlled trial testing the efficacy of corticosteroid therapy versus placebo in fibrotic hypersensitivity pneumonitis.»
Protocol code: APHP240908
Sponsor: Assistance Publique Hopitaux De Paris (Hospital/Clinic/Other health care facility). Phase: Therapeutic confirmatory (Phase III). Countries: France (authorised, recruitment pending).
Therapeutic area(s): Diseases [C] - Respiratory Tract Diseases [C08]
Gender: Female, Male. Age: 18-64 years, 65+ years. Enrolment: 120.
Status: Authorised, recruitment pending. Decision date: 2026-08-03. Results received: No. Last updated: 2026-08-03.

Condition(s): Adult patients with a diagnosis of fibrotic Hypersensitivity Pneumonitis (HP) (“definite” or “high confidence”) after multi-disciplinary discussion (MDD) with a mild to moderate disease severity, and never treated for fibrotic HP.
Product: SOLUPRED 5 mg, comprimé orodispersible, solupred 5mg placebo

Primary endpoint: Absolute change in FVC (% pred) from baseline (inclusion visit, M0) to 6 months (M6) will be compared between the placebo arm and the prednisolone arm.
Endpoint(s): The presence of a causal antigen will be assessed and reported by the investigator. Absolute change in FVC (% pred) from baseline (M0 or inclusion visit) to M6 according to the presence of a causal antigen., PFTs (spirometry and DLco) will be measured at M0, M3, M6 and M12. Absolute and relative changes in FVC (mL and %pred) between M0 and M12 will be compared between the placebo arm and the prednisolone arm. Absolute and relative changes in DLco (mmol/min/kPa and %pred) between M0, M6, and M12, will be compared between the placebo arm and the prednisolone arm., 6MWT will be carried out at M0, M6 and M12 by technicians and/or nurses trained in performing the test. Changes in distance walked during 6MWT (m and %pred) from M0 to M6 and M12 will be compared between the placebo arm and the prednisolone arm., Respiratory QoL will be measured at M0, M6 and M12 using the Saint Georges Hospital Respiratory Questionnaire (SGRQ) and King’s Brief ILD, The proportion of patients who develop a phenotype of PPF within 12 months, as defined according to the ATS/ERS/JRS/ALAT guidelines, will be compared between the placebo arm and the prednisolone arm., The proportion of patients who receive a second-line treatment with corticosteroids, immunosuppressive or antifibrotic therapies within 12 months will be compared between the placebo arm and the prednisolone arm., The proportion of patients who require unplanned hospitalisation and/or develop an AE, as defined by Collard et al., within 12 months will be compared between the placebo arm and the prednisolone arm., PFS, defined by the first occurrence of one of the following events: relative decline in FVC ≥10 in % pred, first AE, lung transplant or death., Adverse events: the Common Terminology Criteria for Adverse Events will be used. The side-effects of corticosteroid therapy will be recorded at M3, M6 and M12. They will be assessed by looking for weight gain compared to M0, measuring blood pressure, collecting

Source: https://euclinicaltrials.eu/ctis-public/view/2025-521591-64-00